EU clinical trial 2024-515547-34-00: Non-inferiority study of a new therapeutic strategy for gout: immediate prescription of a hypouricemia treatment, febuxostat, compared to its deferred administration. FEFACRIGOU
Protocol code: 2017/0386/HP
Sponsor: Centre Hospitalier Universitaire Rouen (Hospital/Clinic/Other health care facility). Phase: Therapeutic confirmatory (Phase III). Countries: France (temporarily halted).
Therapeutic area(s): Diseases [C] - Musculoskeletal Diseases [C05]
Gender: Female, Male. Age: 18-64 years, 65+ years. Enrolment: 128.
Status: Temporarily halted. Start date (EU): 2025-08-12. Decision date: 2024-07-30. Results received: No. Last updated: 2025-07-09.

Condition(s): The gout
Product: Febuxostat Viatris 80 mg film-coated tablets

Primary endpoint: The primary endpoint was the number of days with gout at 42 days (S6), as assessed by the daily logbook (Appendix 7) given to the patient, enabling him to record daily whether or not he had suffered from gout
Endpoint(s): Pain measured by the EVA centimetric scale at 14 (S2), 42 (S6), 84 (S12) and 182 (S26) days, HAQ questionnaire score (Appendix 6) at 14 (S2), 42 (S6), 84 (S12) and 182 (S26) days, SF36 questionnaire score (Appendix 5) at 42 (S6), 84 (S12) and 182 (S26) days and walking perimeter at 14 (S2), 42 (S6), 84 (S12) and 182 (S26) days for patient function, Treatment tolerance assessed by the number of adverse events at 14 (S2), 42 (S6), 84 (S12) and 182 (S26) days, Number of relapses, with crisis defined by assessed criteria (34) (Appendix 4) at 14 (S2), 42 (S6), 84 (S12) and 182 (S26) days, The number of days with gout, assessed using the daily logbook (Appendix 7) given to the patient, which enables him or her to indicate whether or not he or she has suffered from gout on 14 (S2), 84 (S12) and 182 (S26) days

Source: https://euclinicaltrials.eu/ctis-public/view/2024-515547-34-00